EU clinical trial 2024-518011-19-01: DECISION ON OPTIMAL COMBINATORIAL THERAPIES IN IMMUNE-MEDIATED INFLAMMATORY DISEASES (IMIDS) USING SYSTEMS APPROACHES
Protocol code: SPON 2002-24
Sponsor: Cardiff University (Educational Institution). Phase: Therapeutic exploratory (Phase II). Countries: Spain (authorised, recruitment pending).
Therapeutic area(s): Diseases [C] - Immune System Diseases [C20]
Gender: Female, Male. Age: 18-64 years, 65+ years. Enrolment: 10.
Status: Authorised, recruitment pending. Decision date: 2025-10-30. Results received: No. Last updated: 2026-07-14.

Condition(s): Psoriatic Arthritis, Rheumatoid Arthritis
Product: Tyenne 162 mg solution for injection in pre-filled pen

Primary endpoint: Proportion of patients who achieve disease remission at week 24 will be the primary endpoint. Remission will be defined by: • Clinical Disease Activity Index (CDAI) 2.8 or < 2.8 in RA • DAPSA <4 in PsA.
Endpoint(s): To provide proof-of-principle validation of the efficacy of combining TNF and IL-6 inhibitors achieve higher remission than current therapies in RA and PsA., To provide preliminary safety and tolerability data on the selected combination therapy and improvement in disease activity as measured by validated outcome measures.

Source: https://euclinicaltrials.eu/ctis-public/view/2024-518011-19-01